EU clinical trial 2024-518383-12-00: Randomized, controlled, double-blind trial to investigate the effect of colchicin on the endothelial function in patients with CHIP mutations and chronic heart failure with reduced left ventricular function (CHIP-HF)
Protocol code: COL-CHIPHF-P24
Sponsor: Goethe University Frankfurt (Educational Institution). Phase: Therapeutic exploratory (Phase II). Countries: Germany (authorised, recruitment pending).
Therapeutic area(s): Diseases [C] - Cardiovascular Diseases [C14]
Gender: Female, Male. Age: 18-64 years, 65+ years. Enrolment: 100.
Status: Authorised, recruitment pending. Decision date: 2024-11-05. Results received: No. Last updated: 2024-11-05.

Condition(s): Chronic heart failure
Product: Füllstoff DAC in hard gelatine capsules is used as placebo. Füllstoff DAC consists of mannitol 99.5% and colloidal Silicon Dioxide 0.5%, Colchicin Ysat 0,5 mg Tabletten

Primary endpoint: Difference in FMD measurements in HFrEF patients with and without CHIP mutations before and after Colchicin or Placebo treatment

Source: https://euclinicaltrials.eu/ctis-public/view/2024-518383-12-00